EU clinical trial 2024-514656-32-00: An Open-label, Multicentre, Single-Arm Study to Evaluate the Safety, Tolerability, and Pharmacokinetics of VaboremⓇ (Meropenem-Vaborbactam) in Paediatric Population with suspected or confirmed Gram negative infections, including but not restricted to Complicated Urinary Tract Infections.
Protocol code: VABOR-KIDS-01
Sponsor: Menarini Ricerche S.p.A. (Pharmaceutical company). Phase: Therapeutic exploratory (Phase II). Countries: Czechia (ended), Italy (ongoing, recruiting), Spain (ongoing, recruiting), Poland (ongoing, recruiting), France (authorised, recruiting).
Therapeutic area(s): Diseases [C] - Bacterial Infections and Mycoses [C01]
Gender: Female, Male. Age: 0-17 years. Enrolment: 44.
Start date (EU): 2025-01-23. Decision date: 2024-12-19. Results received: No. Last updated: 2026-03-07.
Decision dates by country: PL: 2024-12-23, IT: 2024-12-20, ES: 2025-01-07, FR: 2024-12-19, CZ: 2025-01-09

Condition(s): Suspected or confirmed Gram negative infections
Product: Vaborem 1 g/1 g powder for concentrate for solution for infusion

Primary endpoint: Individual PK parameters derived with updated popPK models: Area under the concentrationtime curve (AUC), maximum plasma concentration (Cmax), time to maximum plasma concentration (Tmax), drug clearance (CL), half-life (t1/2), minimum plasma concentration (Cmin), and steady-state volume of distribution (Vss).
Endpoint(s): Adverse Events (AEs), serious AEs (SAEs), and AE of special interest (AESI), as well as changes in clinical laboratory values, and vital signs following VaboremⓇ administration versus baseline.

Source: https://euclinicaltrials.eu/ctis-public/view/2024-514656-32-00